EU clinical trial 2025-522488-14-00: A clinical study to compare efficacy and safety of two different doses of CagriSema and semaglutide in participants with obesity with or without type 2 diabetes
Protocol code: NN9838-7910
Sponsor: Novo Nordisk A/S (Pharmaceutical company). Phase: Therapeutic confirmatory (Phase III). Countries: Greece (ongoing, recruiting), Portugal (ongoing, recruiting), France (ongoing, recruiting), Slovakia (ongoing, recruiting), Bulgaria (ongoing, recruiting), Netherlands (ongoing, recruiting), Romania (ongoing, recruiting), Italy (ongoing, recruiting), Austria (ongoing, recruiting), Poland (ongoing, recruiting), Hungary (ongoing, recruiting), Spain (ongoing, recruiting), Czechia (ongoing, recruiting), Belgium (ongoing, recruiting).
Therapeutic area(s): Diseases [C] - Nutritional and Metabolic Diseases [C18]
Gender: Female, Male. Age: 18-64 years, 65+ years. Enrolment: 1140.
Status: Ongoing, recruiting. Start date (EU): 2026-07-27. Decision date: 2026-07-27. Results received: No. Last updated: 2026-08-04.
Decision dates by country: AT: 2026-07-28, BE: 2026-07-30, CZ: 2026-07-29, FR: 2026-08-03, GR: 2026-07-30, HU: 2026-07-28, IT: 2026-07-29, PT: 2026-07-29, RO: 2026-08-03, ES: 2026-07-28, NL: 2026-07-28, PL: 2026-07-29, SK: 2026-07-27, BG: 2026-08-04

Condition(s): Participants with obesity with or without type 2 diabetes
Product: semaglutide, cagrilintide semaglutide, cagrilintide semaglutide, cagrilintide semaglutide, semaglutide, semaglutide, semaglutide, semaglutide, cagrilintide semaglutide, cagrilintide semaglutide

Primary endpoint: Relative change in body weight
Endpoint(s): Relative change in body weight, Change in BMI, Achievement of ≥30% weight reduction, Achievement of ≥25% weight reduction, Change in waist circumference, Mean change in body weight, Achievement of ≥20% weight reduction, Achievement of BMI < 30 kg/m2, Achievement of BMI < 27 kg/m2, Achievement of normal BMI (18.5 ≤ BMI < 25), Achievement of waist-to-height ratio of < 0.53, CCI, Ratio to baseline of Total cholesterol, HDL cholesterol, LDL cholesterol, VLDL cholesterol, Triglycerides, Free fatty acids and Non-HDL cholesterol, Change in SF-36v2 physical function, Change in IWQOL-Lite-CT physical function, Achievement of ≥20% weight reduction (Sub-study 2 only), Change in HbA1c, Achievement of HbA1c < 6.5% (only Sub-study 2), Achievement of normal HbA1c < 5.7%, Number of TEAEs, Number of TESAEs, CCI

Source: https://euclinicaltrials.eu/ctis-public/view/2025-522488-14-00